EU clinical trial 2024-513987-24-00: A Phase 1 Study of BMS-986460 in Metastatic Castration-resistant Prostate Cancer
Protocol code: CA1251008
Sponsor: Bristol-Myers Squibb Services Unlimited Company (Pharmaceutical company). Phase: Human Pharmacology (Phase I)- First administration to humans. Countries: France (ongoing, recruiting).
Therapeutic area(s): Diseases [C] - Neoplasms [C04]
Gender: Male. Age: 18-64 years, 65+ years. Enrolment: 22.
Status: Ongoing, recruiting. Start date (EU): 2026-07-16. Decision date: 2026-06-26. Results received: No. Last updated: 2026-06-26.

Condition(s): Metastatic Castration-resistant Prostate Cancer

Source: https://euclinicaltrials.eu/ctis-public/view/2024-513987-24-00